EU clinical trial 2024-519377-18-00: Neoadjuvant [177Lu]Lu-PSMAI&T radioligand therapy (PSMA-RLT) for patients with oligometastatic prostate cancer diagnosed using [68Ga]Ga-PSMA-11 PET imaging followed by radical prostatectomy: A Prospective Phase II Pilot Study
Sponsor: Medical University Of Vienna (Educational Institution). Phase: Therapeutic exploratory (Phase II). Countries: Austria (ongoing, recruiting).
Therapeutic area(s): Diseases [C] - Neoplasms [C04]
Gender: Male. Age: 18-64 years, 65+ years. Enrolment: 10.
Status: Ongoing, recruiting. Start date (EU): 2025-01-14. Decision date: 2025-01-14. Results received: No. Last updated: 2025-11-17.

Condition(s): Prostate Carcinoma
Product: Locametz 25 micrograms kit for radiopharmaceutical preparation, TECEOS Trockenstechampullen

Primary endpoint: • Assess safety and toxicity of neoadjuvant PSMA-RLT and RP

Source: https://euclinicaltrials.eu/ctis-public/view/2024-519377-18-00